EU clinical trial 2023-507317-10-00: A Phase 3, Randomized, Double-Blind Study of Ociperlimab, an Anti-TIGIT Antibody, in Combination With Tislelizumab Compared to Pembrolizumab in Patients With Previously Untreated, PD-L1-Selected, and Locally Advanced, Unresectable, or Metastatic Non-Small Cell Lung Cancer
Protocol code: BGB-A317-A1217-302
Sponsor: Beigene Ltd. (Pharmaceutical company). Phase: Therapeutic confirmatory (Phase III). Countries: Poland (ended), France (ended), Spain (ended), Italy (ended), Germany (ended), Netherlands (ended).
Therapeutic area(s): Diseases [C] - Neoplasms [C04]
Gender: Female, Male. Age: 18-64 years, 65+ years. Enrolment: 135.
Status: Ended. Start date (EU): 2021-05-10. End date (EU): 2025-03-25. Decision date: 2024-03-08. Results received: Yes. Last updated: 2025-04-10.
Decision dates by country: FR: 2024-03-12, NL: 2024-03-08, ES: 2024-03-08, DE: 2024-03-08, IT: 2024-03-11, PL: 2024-03-12

Condition(s): Locally advanced, unresectable, or metastatic non small cell lung cancer
Product: normal saline solution for infusion, Ociperlimab, KEYTRUDA 25 mg/mL concentrate for solution for infusion, Tislelizumab, Ociperlimab

Primary endpoint: • OS (time from the date of randomization to the date of death due to any cause) in the ITT Analysis Set of Arm A (ociperlimab in combination with tislelizumab) and Arm B (pembrolizumab followed by placebo)
Endpoint(s): • PFS as assessed by investigators (time from the date of randomization to the date of the first objectively documented tumor progression per RECIST v1.1, or death, whichever occurs first) in the ITT Analysis Set of Arm A (ociperlimab in combination with tislelizumab) and Arm B (pembrolizumab followed by placebo), • ORR as assessed by investigators (proportion of patients with a documented, confirmed complete response [CR] or partial response [PR] per RECIST v1.1) and DOR as assessed by investigators (time from the first determination of an objective response per RECIST v1.1 until the first documentation of progression or death, whichever occurs first) in Arm A (ociperlimab in combination with tislelizumab) and Arm B (pembrolizumab followed by placebo), • HRQoL as assessed via patient reported outcomes (PRO) using the European Organization for Research and Treatment of Cancer Quality of Life Questionnaire Core 30 (EORTC QLQ-C30), its lung cancer module Quality of Life Questionnaire Lung Cancer 13 (QLQ-LC13), and the 5 Level EuroQol 5 Dimension (EQ-5D-5L) questionnaire in Arm A (ociperlimab in combination with tislelizumab) and Arm B (pembrolizumab followed by placebo)., • TTD, defined as time from randomization to the first occurrence of worsening scores (10-point change, to be defined in the Statistical Analysis Plan [SAP] if otherwise) for 2 consecutive assessments or 1 assessment followed by death from any cause before the next scheduled data collection, • The incidence and severity of adverse events (AEs) according to National Cancer Institute Common Terminology Criteria for Adverse Events Version 5.0 (NCI CTCAE v5.0) in Arm A (ociperlimab in combination with tislelizumab)

Source: https://euclinicaltrials.eu/ctis-public/view/2023-507317-10-00